EU clinical trial 2023-508556-18-00: A Phase I Study to Evaluate Safety and Immunogenicity of DNA Vaccine N-pVAX1 against Crimean Congo Hemorrhagic Fever (CCHF-NP-1)
Protocol code: CCHF-NP-1
Sponsor: Karolinska Institutet (Educational Institution). Phase: Human Pharmacology (Phase I)- First administration to humans. Countries: Sweden (ended).
Therapeutic area(s): Diseases [C] - Virus Diseases [C02]
Gender: Female, Male. Age: 18-64 years. Enrolment: 15.
Status: Ended. Start date (EU): 2024-09-25. End date (EU): 2026-03-17. Decision date: 2024-05-03. Results received: No. Last updated: 2024-08-06.

Condition(s): Crimean Congo Hemorrhagic Fever

Source: https://euclinicaltrials.eu/ctis-public/view/2023-508556-18-00